EU clinical trial 2024-519322-20-00: CAPRI-3 Phase 3 clinical study to evaluate the use of continuing cetuximab treatment beyond first line progression in molecular selected metastatic colorectal cancer patients
Sponsor: Gruppo Oncologico Dell'Italia Meridionale (Patient organisation/association). Phase: Therapeutic confirmatory (Phase III). Countries: Italy (ongoing, recruiting), Spain (ongoing, recruiting).
Therapeutic area(s): Diseases [C] - Neoplasms [C04]
Gender: Female, Male. Age: 18-64 years, 65+ years. Enrolment: 360.
Status: Ongoing, recruiting. Start date (EU): 2025-07-21. Decision date: 2025-06-12. Results received: No. Last updated: 2026-06-16.
Decision dates by country: ES: 2025-06-12, IT: 2025-06-12

Condition(s): metastatic colorectal cancer
Product: FLUOROURACIL, OXALIPLATIN, IRINOTECAN, BEVACIZUMAB, CETUXIMAB, CALCIUM LEVOFOLINATE

Primary endpoint: The Overall Response Rate (ORR) according to RECIST 1.1 defined as the proportion of patients who have a partial or complete response to therapy. An external radiology department will receive the images of radiological re-evaluations from the participating sites. The imaging will be assessed by a blind operator.
Endpoint(s): Progression Free Survival (PFS) according to RECIST 1.1 defined as the time from random assignment in the clinical trial to disease progression or death from any cause., The Overall Survival (OS) defined as the interval from enrollment to death for every cause., The safety profile of the trial drugs as measured by the incidence of AEs, SAEs, clinical laboratory assessments, vital signs, physical examination, ECG parameters, and ECOG PS.

Source: https://euclinicaltrials.eu/ctis-public/view/2024-519322-20-00